EU clinical trial 2025-520466-22-00: Randomised, Open-label, Phase III Study of AZD5335 Versus Mirvetuximab Soravtansine in FRα-high and AZD5335 Versus Investigator’s Choice Chemotherapy in FRα-low Expressing High-grade Platinum-resistant Epithelial Ovarian Cancer Patients (TREVI-OC-01)
Protocol code: D8991C00001
Sponsor: AstraZeneca AB (Pharmaceutical company). Phase: Therapeutic confirmatory (Phase III). Countries: Ireland (authorised, recruitment pending), Greece (authorised, recruitment pending), Czechia (authorised, recruitment pending), France (ongoing, recruiting), Sweden (authorised, recruitment pending), Belgium (ongoing, recruiting), Denmark (authorised, recruitment pending), Spain (ongoing, recruiting), Italy (ongoing, recruiting), Germany (authorised, recruitment pending).
Therapeutic area(s): Diseases [C] - Pathological Conditions, Signs and Symptoms [C23]
Gender: Female. Age: 18-64 years, 65+ years. Enrolment: 309.
Start date (EU): 2026-04-29. Decision date: 2026-03-27. Results received: No. Last updated: 2026-06-11.
Decision dates by country: BE: 2026-03-27, DK: 2026-03-30, IE: 2026-04-02, ES: 2026-03-31, IT: 2026-06-08, SE: 2026-03-27, FR: 2026-04-01, GR: 2026-03-30, DE: 2026-05-13, CZ: 2026-03-30

Condition(s): Advanced Platinum-resistant Epithelial Ovarian Cancer
Product: AZD5335, PACLITAXEL, DOXORUBICIN HYDROCHLORIDE, LIPOSOMAL, TOPOTECAN, MIRVETUXIMAB SORAVTANSINE, DOXORUBICIN HYDROCHLORIDE, LIPOSOMAL

Primary endpoint: Progression free Survival (PFS): PFS is defined as the time from randomization to radiographic progression as assessed by the Investigator per RECIST v1.1, or death due to any cause.
Endpoint(s): Overall survival (OS): OS is defined as the time from randomisation until the date of death due to any cause.

Source: https://euclinicaltrials.eu/ctis-public/view/2025-520466-22-00